EU clinical trial 2024-520262-58-01: Multicentre, open-label, randomized controlled non-inferiority trial comparing single dose intrathecal morphine and continuous thoracic epidural analgesia for multimodal analgesia in open colorectal surgery: the ColoREDIT protocol
Protocol code: ColoREDIT
Sponsor: Region Vaestmanland (Hospital/Clinic/Other health care facility). Phase: Therapeutic use (Phase IV). Countries: Sweden (authorised, recruitment pending).
Therapeutic area(s): Analytical, Diagnostic and Therapeutic Techniques and Equipment [E] - Anesthesia and Analgesia [E03]
Gender: Female, Male. Age: 18-64 years, 65+ years. Enrolment: 124.
Status: Authorised, recruitment pending. Decision date: 2026-01-28. Results received: No. Last updated: 2026-01-28.

Condition(s): All diseases requiring resective colorectal surgery with a midline incision.
Product: Morphine Unimedic 1 mg/ml injektionsvätska, lösning, Fentanyl citrate-Kalceks 0,05 mg/ml šķīdums injekcijām, Adrenaline (Epinephrine) 1:1,000 Solution for Injection, Marcain Polyamp Steripack 0.5%, Bupivacaine Hydrochloride 0.1% w/v Solution for Infusion

Primary endpoint: Mean Quality of Recovery-15 Swedish version for post operative day 2 with adjustment for preoperative score. The minimally clinically important difference (MCID) between treatment groups is set to 8.
Endpoint(s): Mean Quality of Recovery-15 Swedish version postoperative day 1-7, 30 and 365 with adjustment for preoperative score, Pain intensity at rest and activity using 11 point numeric rating scale and verbal rating scale on postoperative day 0-discharge or atleast postoperative day 7, postoperative day 30 and 365. MCID 1,0., Patient satisfaction with postoperative pain management using Likert scale ranging very satisfied, satisfied, neutral, dissatisfied, very dissatisfied on postoperative day 1-discharge or atleast postoperative day 7, postoperative day 30 and 365., Failure of primary analgesic method defined as persistent insufficient analgesia with NRS ≥4 for more than 1 hour despite adequate use of epidural and/or additional systemic analgesia. Postoperative placement of TEA catheter, administration of intrathecal morphine or peripheral nerve blockade. Postoperative need for esketamine-infusion, lidocaine-infusion or PCIVA morphine. Premature stop of TEA. Measured on POD 0 - discharge (or at least POD7)., Cumulative dose of opioids using Morphine Milligram Equivalents and MCID 10 mg IV or 40% per 24 h. Measured on POD 0 - discharge (or at least POD7)., Long term opioid requirement, defined as still taking opioids for abdominal pain on POD30 and/or POD365., Length of stay. LoS measured in days, defined as time from operation to discharged from hospital. MCID is defined as 1 day., Mortality. Registered at discharge, POD30, POD365, Days alive and home registred at POD 30 and POD 365. MCID is defined as 3 days at POD30., Health related quality of life using EQ-5D-5L. Registered at baseline at preanaesthetic clinic, POD1-discharge (at least POD7), POD30, POD365, Postoperative delirium using Nu-DESC score, score > 2 is considered delirium. Registered at baseline at preanaesthetic clinic, POD0-discharge (at least POD7), Mobilisation using modified surgical intensive care unit optimal mobilisation score. Measured as time to mSOMS ≥ 2. Assessments at POD0-discharge (at least POD7)., Subjective discomfort and maximum pain during neuraxial procedure. Subjective discomfort using VRS 0, no discomfort; 1, minimal; 2, moderate; 3, severe and Maximum pain related to ITM and TEA administration using NRS-11. Assessed immediately after neuraxial procedure., Time to administer neuraxial block., Time from patient arrival to induction of anaesthesia., Time from operation finished to extubation., Intravenous fluid dose. Intraoperative: Total volume intravenous fluid dose in ml divided by duration of operation in minutes. Postoperative: Total volume intravenous fluid in ml per day. Registered intraoperative, POD0-discharge, Vasopressor dose. Intraoperative: Total dose for each vasopressor in mg divided by duration of operation in minutes. Postoperative: Total dose for each vasopressor in mg. Registered intraoperatively and on POD1., Urine output during operation and on postoperative day 1. Intraoperative: Total volume in ml divided by duration of operation in hours Postoperative: Total volume in ml divided by duration of stay in PACHU in hours., Acute kidney injury during hospital stay using KDIGO definition. Routinely measured creatinine from preoperative to discharge will be recorded., Respiratory depression. Desaturation defined as PaO2<8 kPa on room air or SpO2 < 90% and requiring oxygen therapy or. Bradypnoea defined as respiratory frequency <10 breaths/minute. Need for iv naloxone treatment due to respiratory insufficiency. Hypoventilation defined as pCO2 >6,6 kPa. Need for mechanical ventilation. Monitored according to national guidelines. Registered POD 0 to discharge., Sedation using richmond agitation-sedation scale. Oversedation is defined as Richmond Agitation-Sedation Scale < -2. Registered POD0-discharge., Motor block using Bromage score. Registered POD0-discontinuation of TEA or at least POD3., Incidence of postdural puncture headache. Registered at POD0-discharge., Incidence of postoperative nausea and vomiting (PONV). Registered postoperative at 0-6h, 6-24h and overall during hospital stay., Incidence of pruritus. Registered postoperative at 0-6h, 6-24h and overall during hospital stay., Urinary catheter needed due to urinary retention. POD0-discharge (at least POD7)., Grading of complications according to Clavien-Dindo at POD30., Time to gastrointestinal recovery. Measured as time from end of surgery to time to return of bowel function (time to flatus and time to passing first stool) and time to first oral intake. Registered at POD1-discharge., Sleep disturbance. Assessment using the question “How did you sleep last night?” with predetermined options “excellent”, “neither well nor badly” and “badly" on POD1-discharge (atleast POD7), POD30 and POD365., Time to start of adjuvant chemotherapy in malignant cases. Cut-off at <8 weeks or >8 weeks. Registered at POD365., Hypotension. Non-invasive or invasive measurement. Intraoperative hypotension defined as MAP < 65 for more than 5 minutes. Postoperative hypotension defines as MAP < 65 for more than 5 minutes and/or need for fluid bolus and/or need for vasopressor to maintain MAP > 65 mmHg. Registered preoperative, intraoperative, POD0-discharge

Source: https://euclinicaltrials.eu/ctis-public/view/2024-520262-58-01